EU clinical trial 2023-503499-25-00: Avoid With locoregional Analgesia Persistant Postoperative Pain After Surgery In Children
Protocol code: RC23_0009
Sponsor: Centre Hospitalier Universitaire De Nantes (Hospital/Clinic/Other health care facility). Phase: Therapeutic use (Phase IV). Countries: France (ongoing, recruiting).
Therapeutic area(s): Analytical, Diagnostic and Therapeutic Techniques and Equipment [E] - Anesthesia and Analgesia [E03]; Analytical,Diagnostic,Therapeutic Techniques and Equipment [E]-Surgical Procedures, Operative [E04]
Gender: Female, Male. Age: 0-17 years. Enrolment: 222.
Status: Ongoing, recruiting. Start date (EU): 2024-06-06. Decision date: 2024-02-12. Results received: No. Last updated: 2026-03-12.

Condition(s): Post-operative pain after surgery
Product: MORPHINE (CHLORHYDRATE) LAVOISIER 10 mg/ml, solution injectable, PARACETAMOL B BRAUN 10 mg/ml, solution pour perfusion, NALBUPHINE RENAUDIN 20 mg/2 ml, solution injectable, CARBOCAINE 10 mg/ml, solution injectable, SUXAMETHONIUM AGUETTANT 10 mg/mL, solution injectable en seringue préremplie, SUFENTANIL VIATRIS 5 microgrammes/ml, solution injectable (IV ou péridurale), IBUPROFENE EG 200 mg, comprimé pelliculé, DOLIPRANE 150 mg, poudre pour solution buvable en sachet-dose, TOPALGIC 100 mg/ml, solution buvable, PROPOFOL LIPURO 1 % (10 mg/ml), émulsion injectable ou pour perfusion, DEXAMETHASONE VIATRIS 4 mg/1 ml, solution injectable en ampoule, SEVOFLURANE BAXTER 1 ml/ml, liquide pour inhalation par vapeur, ZOPHREN 4 mg/5 ml, sirop, INTRALIPIDE 20 POUR CENT, émulsion pour perfusion., KETOPROFENE MEDISOL 100 mg/4 ml, solution à diluer pour perfusion

Primary endpoint: Measurement of pain by a Numerical Rating Scale (NRS) 3 months after pediatric orthopedic trauma surgery
Endpoint(s): Response score to DN4 neuropathic pain screening questionnaire ≥4/10 at 3, 6 and 12 months., 1st EN score for immediate post-operative care in the Post-Interventional Monitoring Room, Presence of pain assessed by numerical scale >3/10 at 6 and 12 months post-surgery, The number of patients experiencing at least one episode of nausea and one episode of vomiting in the Post-Interventional Monitoring Room., Duration in minutes of monitoring in the Post-Interventional Monitoring Room, The dose of intravenous opiates received intraoperatively, the dose of intravenous opiates titrated in the Post-Interventional Monitoring Room and the dose of opiates received in the hospital ward during the first 24 hours postoperatively., The dose of IV morphine received in the ICU.

Source: https://euclinicaltrials.eu/ctis-public/view/2023-503499-25-00